EU clinical trial 2025-521244-38-00: An Open-label Study of the Safety, Pharmacokinetics, Pharmacodynamics, and Efficacy of 12-month Treatment with Migalastat in Pediatric Subjects (aged 2 to < 12 years) with Fabry Disease and Amenable GLA Variants
Protocol code: AT1001-033
Sponsor: Amicus Therapeutics Inc. (Pharmaceutical company). Phase: Therapeutic confirmatory (Phase III). Countries: Spain (authorised, recruitment pending), Germany (authorised, recruitment pending), Belgium (authorised, recruitment pending).
Therapeutic area(s): Diseases [C] - Nutritional and Metabolic Diseases [C18]
Gender: Female, Male. Age: 0-17 years. Enrolment: 3.
Status: Authorised, recruitment pending. Decision date: 2025-12-17. Results received: No. Last updated: 2026-04-24.
Decision dates by country: ES: 2025-12-22, BE: 2025-12-22, DE: 2025-12-17

Condition(s): Fabry disease
Product: Migalastat Hydrochloride Dispersible Tablet

Primary endpoint: Pharmacokinetics: Derived pharmacokinetic parameters for dosing confirmation will be estimated based on concentrations of migalastat in plasma., Safety: incidence of TEAEs, SAEs, and AEs leading to discontinuation of study drug; change from baseline over time in clinical laboratory test results; change from baseline over time in vital signs;change from baseline over time in physical examination findings, change from baseline over time in body weight and height; change from baseline over time in ECG results; change from baseline to Month 12/ET in echocardiogram parameters; change from baseline to Month 12/ET in Tanner stage (for female subjects aged ≥ 8 years and male subjects aged ≥ 9 years)

Source: https://euclinicaltrials.eu/ctis-public/view/2025-521244-38-00